EU clinical trial 2023-505880-35-00: Phase II-III study to assess efficacy and safety of sublingual immunotherapy in patients suffering from grass pollen allergy
Sponsor: ROXALL Medizin GmbH (Pharmaceutical company). Phase: Phase II and Phase III (Integrated). Countries: Germany (ended).
Therapeutic area(s): Diseases [C] - Immune System Diseases [C20]
Gender: Female, Male. Age: 18-64 years. Enrolment: 30.
Status: Ended. Start date (EU): 2023-11-10. End date (EU): 2024-11-07. End date: 2025-01-03. Decision date: 2023-09-22. Results received: No. Last updated: 2023-11-15.

Condition(s): Moderate-to-severe allergic rhinitis / rhinoconjunctivitis due to grass pollen for at least two years according to the Allergic Rhinitis and its Impact on Asthma (ARIA) guideline
Product: PRICK TEST Lieschgras LETI, 30 HEP/ml Pricktestlösung, SULGEN® Spray Phleum pratense mid dose, Provokationstest Lieschgras LETI, 30 HEP/ml Pulver, Lösungsmittel und Verdünnungsmittel zur Herstellung einer Provokationstestlösung, SULGEN® Spray Phleum pratense low dose, ALK-prick SQ - 312 Beifuß - 10 HEP - Lösung für den Pricktest, PRICK TEST Beifuss LETI, 30 HEP/ml Pricktestlösung., ALK-prick N - 402 Alternaria alternata (tenuis) - 1:20 G/V - Lösung für den Pricktest, ALK-prick SQ - 555 Katzenhaare - 10 HEP - Lösung für den Pricktest, ALK-prick Positiv-Kontrolle ist ein Histaminpräparat für die Pricktestung., PRICK TEST Alternaria alternata LETI, 30 HEP/ml Pricktestlösung., PRICK TEST Hundeepithel LETI, 30 HEP/ml Pricktestlösung., PRICK TEST Katzenepithel LETI, 30 HEP/ml Pricktestlösung., ALK-prick SQ 553 Hundehaare 10 HEP Lösung für den Pricktest, MometaHEXAL Heuschnupfenspray, 50 Mikrogramm/Sprühstoß Nasenspray, Suspension Zur Anwendung bei Erwachsenen, ALK-prick SQ - 225 Wiesenlieschgras - 10 HEP - Lösung für den Pricktest, SULGEN® Spray Phleum pratense high dose, Prednisolon AL 10 mg Tabletten, Prick Test LETI Negativkontrolle Pricktestlösung, Sublingual placebo preparation with appearance, smell, taste and excipients identical to verum, but without the active substance, i. e. allergen extract., ALK-prick SQ - 503 Milbe Dermatophagoides pteronyssinus, 10 HEP, Lösung für den Pricktest, ALK-prick Negativ-Kontrolle Pricktestlösung, ALK-prick SQ - 108 Birke - 10 HEP - Lösung für den Pricktest, Lorano akut, 10 mg Tabletten, ALK-prick N - 302 Ragweed (Ambrosia) - 1:100 G/V - Lösung für den Pricktest, Prick Test Histamin LETI Positivkontrolle 10 mg/ml Pricktestlösung, PRICK TEST Dermatophagoides pteronys- sinus LETI, 100 HEP/ml Pricktestlösung., PRICK TEST Birkenpollen LETI, 30 HEP/ml Pricktestlösung.

Primary endpoint: The primary (efficacy) endpoint is defined as the absolute differences in mean CSMS (Combined Symptom and Medication Score) during Peak Grass Pollen Period (PGPP) of each active treatment group compared to placebo treatment group.
Endpoint(s): Absolute and relative differences in mean CSMS during Grass Pollen Season (GPS) between active and placebo treatment groups., Absolute and relative differences in mean dSS during PGPP and GPS, Absolute and relative differences in mean dMS during PGPP and GPS, Global Rhinoconjunctivitis Discomfort with a Visual Analogue Scale (VAS), Change in Rhinoconjunctivitis quality of life questionnaire (RQLQ) between active and placebo treatment groups comparing basal and post-treatment scoring, Well and severe days: A well day is defined as a day without administration of any rescue medication (dMS = 0) and with dSS < 0.34 (range 0-3). A severe day is defined (acc. to Pfaar et al. 2014a) as a day with a single score = 3 in any of the six symptoms. Percentages of well and severe days will be calculated for each subject as the number of well or severe days in the PGPP and GPS in relation to the number of days comprising both periods, Symptom-free days are defined as the days with absence of symptoms (dSS = 0) and without administration of any rescue medication (dMS = 0), expressed as percentage of days during the PGPP and GPS, tNPT titrated Nasal Provocation Test: To assess the efficacy of each dose of SULGEN® Spray Phleum pratense compared to placebo. Defined as percentage of patients with an increased dosing step and the change in number of dosing steps needed to provoke a positive response in the titrated nasal provocation test (tNPT) post-treatment compared with pre-treatment (i. e. any improvement) in each of the four treatment groups. This is based on the change of the response to nasal provocation (tNPT) with

Source: https://euclinicaltrials.eu/ctis-public/view/2023-505880-35-00